EU clinical trial 2025-521451-23-00: A phase III, international, multiCenter, randomized, paraLlel-group, Endoscopist-blinded non-inferiority study of the efficAcy, safety and patient acceptance of mannitol veRsus Plenvu® in boWel prepAration for elective colonoscopY. CLEARWAY
Protocol code: Mannitol_01-2024
Sponsor: Ntc S.r.l. (Pharmaceutical company). Phase: Therapeutic confirmatory (Phase III). Countries: Belgium (ended), Spain (ended), Sweden (ended), Poland (ended), Italy (ended).
Therapeutic area(s): Analytical, Diagnostic and Therapeutic Techniques and Equipment [E] - Investigative Techniques [E05]
Gender: Female, Male. Age: 18-64 years, 65+ years. Enrolment: 520.
Status: Ended. Start date (EU): 2025-09-03. End date (EU): 2026-03-13. Decision date: 2025-07-16. Results received: No. Last updated: 2026-02-11.
Decision dates by country: IT: 2025-07-16, PL: 2025-07-18, ES: 2025-07-17, SE: 2025-07-16, BE: 2025-07-16

Condition(s): Subjects scheduled for elective colonoscopy performed according to ESGE (European Society of Gastrointestinal Endoscopy) guidelines.
Product: Mannitol, MACROGOL, COMBINATIONS

Primary endpoint: Proportion of patients with adequate bowel cleansing, defined as BBPS total score ≥ 6, with a score for each of the three colon segments (right; transverse, including flexures; and left, including sigmoid and rectum) ≥ 2 after standard washing and air or CO2 insufflation for luminal distension.
Endpoint(s): Adenoma detection rate, defined as the proportion of patients ≥ 45 years old without IBD undergoing colonoscopy who have at least one lesion detected., Caecal intubation rate, defined as the proportion of patients undergoing colonoscopy with ileocecal junction appendiceal orifice visible to the endoscopist., Proportion of patients undergoing colonoscopy who have to repeat the procedure due to inadequate intestinal cleansing to resolve, at the discretion of the endoscopist, the clinical issue underlying the request for colonoscopy., Proportion of patients undergoing colonoscopy with presence of colonic bubbles assessed through the Colon Endoscopic Bubble Scale (CEBuS)., Number, appearance, size, location, and histological examination of neoplastic and inflammatory colorectal lesions., Adherence: study drug completely taken, partially taken, not taken., Ease of use: numeric rating scale (NRS) (0 = very difficult to 10 = very easy)., Taste: NRS (0 = terrible to 10 = very good)., Willingness to reuse the preparation (yes/no)., Satisfaction with bowel preparation compared to cleansing agent used for previous colonoscopy, Incidence of adverse events starting from the beginning of study drug administration., Incidence of drug-related adverse events starting from the beginning of study drug self-administration, Proportion of patients with clinically significant change from baseline of haematological and chemical parameters 4 hours and 8 hours after completion of study drug self-administration, where clinically significant means that in the Investigator’s opinion the change needs an additional control or a medical intervention., Proportion of patients with clinically significant change from baseline of heart rate, systolic and diastolic blood pressure measured from the beginning of study drug self-administration to the end of study, as well as clinically significant change of oxygen saturation during colonoscopy, where clinically significant means that in the Investigator’s opinion the change needs an additional control or a medical intervention., PK sub-study: Maximum observed concentration (Cmax)., PK sub-study: Time to maximum observed concentration (tmax)., PK sub-study: Area under concentration-time curve, from 0 to the last blood sampling time point with measurable concentration (i.e., the last quantifiable timepoint) (AUC0-t0-t or AUClast)., PK sub-study: Terminal elimination half-life (t1/2).

Source: https://euclinicaltrials.eu/ctis-public/view/2025-521451-23-00